EU clinical trial 2023-507763-18-01: Progesterone for prEventing Preterm births in women with PlacEnta pRevia (PEPPER-trial)
Sponsor: Amsterdam UMC (Hospital/Clinic/Other health care facility). Phase: Therapeutic use (Phase IV). Countries: Netherlands (ongoing, recruiting).
Therapeutic area(s): Diseases [C] - Female Urogenital Diseases and Pregnancy Complications [C13]
Gender: Female. Age: In utero, 0-17 years, 18-64 years. Enrolment: 142.
Status: Ongoing, recruiting. Start date (EU): 2024-05-21. Decision date: 2024-02-16. Results received: No. Last updated: 2024-06-26.

Condition(s): Placenta previa, preterm birth
Product: PROGESTERONE

Primary endpoint: Number of PTB before 37 weeks of gestation
Endpoint(s): 1. sPTB/iPTB <37wks, 2. PTB >24wks, 3. Total PTB, sPTB, iPTB <28/32/34wks, 4. Mean gestational age, 5. Incidence of <10th/3rd percentile birthweight, 6. Umbilical cord blood pH (arterial/venous), 7. Apgar <7 at 5 mins, 8. NICU admissions (>24 hrs, hrs in NICU), 9. Components of composite outcome, 10. Planned/unplanned CS, 11. Admission for antenatal blood loss (incidence), 12. Threatened preterm birth (incidence).

Source: https://euclinicaltrials.eu/ctis-public/view/2023-507763-18-01